EU clinical trial 2024-515090-96-00: A Phase 3b/4, Double-masked, Randomized, International, Parallel-assignment, Multicenter Trial in Patients with Thyroid Eye Disease to Evaluate the Safety and Tolerability of Different Dosing Durations of Teprotumumab
Protocol code: HZNP-TEP-402
Sponsor: Horizon Therapeutics USA Inc. (Pharmaceutical company). Phase: Phase III and phase IV (Integrated). Countries: France (ended), Italy (ended), Germany (ended), Spain (ended).
Therapeutic area(s): Diseases [C] - Eye Diseases [C11]
Gender: Female, Male. Age: 18-64 years, 65+ years. Enrolment: 214.
Status: Ended. Start date (EU): 2022-05-10. End date (EU): 2025-12-10. End date: 2025-12-20. Decision date: 2024-07-03. Results received: No. Last updated: 2026-01-19.
Decision dates by country: ES: 2024-07-03, IT: 2024-07-22, FR: 2024-07-04, DE: 2024-07-05

Condition(s): Thyroid Eye Disease
Product: Teprotumumab, Placebo will consist of a normal saline (0.9% NaCl) solution and will be administered in 100 mL or 250 mL infusion bags, as appropriate, per weight-based dosing volumes.

Primary endpoint: The percentage of patients who experience at least 1 TEAE and the percentage of patients who experience at least 1 treatment-emergent AESI during treatment with teprotumumab. . The percentage of patients who receive re-treatment
Endpoint(s): Mean change from Baseline in proptosis measurement in the study eye., Proptosis responder rate (percentage of patients with a ≥2-mm reduction from Baseline in proptosis in the study eye, without deterioration [≥2-mm increase] of proptosis in the fellow eye)., The overall responder rate (percentage of patients with ≥2-point reduction in CAS AND ≥2-mm reduction in proptosis from Baseline in the study eye, provided there is no corresponding deterioration [≥2 point/mm increase] in CAS or proptosis in the fellow eye)., The binocular diplopia responder rate (percentage of patients with baseline binocular diplopia >0 who have a reduction of ≥1 grade)., The binocular diplopia resolution rate (percentage of patients with baseline binocular diplopia >0 who have no binocular diplopia)., Mean change from Baseline in the GO-QoL questionnaire appearance and visual functioning sub-scales., Rate of flares at the end of the Initial Follow-up Period., Time to proptosis response from the first infusion until the end of the Initial Treatment Period., CAS: - Proportion of patients with a CAS ≥3 at Baseline who have a CAS of 0 or 1 at the end of the Initial Treatment Period - Proportion of patients who improve on individual questions on the CAS for - spontaneous orbital pain - gaze-evoked orbital pain., Proportion of patients with complete response at the end of the Initial Follow-up Period, as defined by durability of complete response, Proportion of patients with response at the last assessment in the Initial Follow-up Period, as defined by durability of response at the last assessment in the Initial Follow-up Period., Mean change from Baseline over time in disease biomarkers for patients with a Baseline CAS ≥3., "All other endpoints, except the time to proptosis response, rate of flares at the end of the Initial Follow-up Period, durability of complete response and durability of response at the last assessment in the Initial Follow-up Period, will be assessed by randomized cohort at the end of the Initial Treatment Period, at the end of the Initial Follow-up Period., For patients who require re-treatment, the same endpoints will be estimated at the end of the 24-week Re-treatment Period., Safety and Tolerability Endpoints 1. Incidence of TEAEs, SAEs, TEAEs resulting in premature discontinuation of treatment and treatment-emergent AESIs (infusion reactions, hyperglycemia, hearing impairment, new onset IBD and exacerbation of IBD). ", 2. Incidence of ≥Grade 3 TEAEs. 3. Incidence of ≥Grade 3 laboratory evaluations, in which CTCAE grading is available. 4. The results of best-corrected visual acuity. PK and ADA Endpoints 1. Peak and trough concentrations of teprotumumab. 2. ADA incidence and titers."

Source: https://euclinicaltrials.eu/ctis-public/view/2024-515090-96-00